EU clinical trial 2025-520845-61-00: Assessing the efficacy of Elixirium thymi compositum in the treatment of acute bronchitis in pediatric patients (EXOTIC): A double-blind, randomized, placebo-controlled, phase 4 study
Protocol code: EXOTIC
Sponsor: Semmelweis University (Educational Institution). Phase: Therapeutic use (Phase IV). Countries: Hungary (authorised, recruitment pending).
Therapeutic area(s): Diseases [C] - Virus Diseases [C02]; Diseases [C] - Respiratory Tract Diseases [C08]
Gender: Female, Male. Age: 0-17 years. Enrolment: 56.
Status: Authorised, recruitment pending. Decision date: 2025-05-07. Results received: No. Last updated: 2025-05-07.

Condition(s): Acute bronchitis
Product: Elixirium thymi compositum (fono viii.) placebo, Elixirium thymi compositum FoNo VIII. Naturland belsőleges oldat

Primary endpoint: Efficacy of the investigational product based on the Bronchitis Severity Score
Endpoint(s): Safety and tolerability by the reported adverse events

Source: https://euclinicaltrials.eu/ctis-public/view/2025-520845-61-00